EU clinical trial 2024-518534-81-00: Investigate the efficacy and safety of a bio-marker driven cetuximab-based treatment regimen over 3 treatment lines in mCRC patients with RAS/BRAF wt tumors at start of first line.
Protocol code: CAPRI-2
Sponsor: Gruppo Oncologico Dell'Italia Meridionale (Patient organisation/association). Phase: Therapeutic exploratory (Phase II). Countries: Italy (ongoing, recruiting).
Therapeutic area(s): Diseases [C] - Neoplasms [C04]
Gender: Female, Male. Age: 18-64 years, 65+ years. Enrolment: 200.
Status: Ongoing, recruiting. Start date (EU): 2021-07-01. Decision date: 2024-12-09. Results received: No. Last updated: 2026-07-07.

Condition(s): metastatic colorectal cancer
Product: BEVACIZUMAB, CALCIUM LEVOFOLINATE, FLUOROURACIL SODIUM, IRINOTECAN, CETUXIMAB, Lonsurf 15 mg/6.14 mg film-coated tablets, REGORAFENIB, OXALIPLATIN

Primary endpoint: Response rate (RR) for each line of treatment according to Response Evaluation Criteria in Solid Tumors (RECIST) v1.1 in patients with RAS/BRAF wild type (WT) mCRC.
Endpoint(s): Progression Free Survival (PFS): measured from the start of therapy until the first observation of disease progression or death due to any cause., Overall Survival (OS): calculated from the start of the study treatment until death., Safety: Adverse events graded according NCI CTCAE v 5.0., Molecular profiles of tumor tissue and liquid biopsy: molecular analysis of formalin fixed paraffin embedded (FFPE) tumor tissue, which is representative of the primary tumor or of a metastatic site at the diagnosis of mCRC, will be performed before the first line, whilst blood samples for liquid biopsy will be collected before each line of treatment.

Source: https://euclinicaltrials.eu/ctis-public/view/2024-518534-81-00